EU clinical trial 2023-504672-22-00: A Phase IIIb Multicenter, Single-Arm, Open-Label Surveillance Study of Susceptibility to Baloxavir Marboxil in Pediatric Patients with Influenza and Transmission of Influenza to Household Contacts
Protocol code: CV44536
Sponsor: F. Hoffmann-La Roche AG (Pharmaceutical company). Phase: Therapeutic confirmatory (Phase III). Countries: Spain (ended), Bulgaria (ongoing, recruiting), Poland (ongoing, recruiting).
Therapeutic area(s): Diseases [C] - Respiratory Tract Diseases [C08]; Health Care [N] - Environment and Public Health [N06]
Gender: Female, Male. Age: 0-17 years. Enrolment: 310.
Start date (EU): 2023-11-24. Decision date: 2023-10-23. Results received: No. Last updated: 2026-08-07.
Decision dates by country: ES: 2023-10-23, PL: 2023-10-23, BG: 2023-10-23

Condition(s): Influenza
Product: Xofluza 2 mg/mL granules for oral suspension

Primary endpoint: Part A (Surveillance) 1. Incidence of resistance-associated pre-treatment substitutions determined at baseline (Day 1), Part A (Surveillance) 2. Incidence of resistance-associated treatment-emergent substitutions based on sampling on Days 4, 6 and 10
Endpoint(s): Part A (Surveillance) 1. Incidence of resistance-associated treatment-emergent substitutions by age groups (< 5 years [also < 1 year, ≥ 1 year to < 5 years], and 5 to < 12 years), Part A (Surveillance) 2. Incidence of novel treatment-emergent mutations in PA, Part A (Surveillance) 3. Incidence of resistance-associated treatment-emergent substitutions by baseline vaccination status of patient (vaccinated vs not vaccinated in the last 6 months), Part A (Surveillance) 4. Incidence of influenza virus type (A or B) and subtype (A/H1 or A/H3) in participants by study period, Part A (Surveillance) 5. Viral titers by quantitative reverse transcriptase-polymerase chain react (RT-PCR) at baseline and post-baseline timepoints, Part A (Surveillance) 6. The susceptibility to baloxavir marboxil by phenotyping of virus with novel PA substitutions, Part A (Surveillance) 7. Incidence and severity of adverse events, serious adverse events, with severity determined according to National Cancer Institute (NCI) Common Terminology Criteria for Adverse Events (CTCAE) version 5.0, Part B (Transmission) 8. Incidence of transmission of influenza virus by Day 6 confirmed by central RT-PCR, with virus subtype consistent with the IP., Part B (Transmission) 9. Incidence of transmission of influenza virus by Day 10 confirmed by central RT-PCR, with virus subtype consistent with the IP., Part B (Transmission) 10. Incidence of influenza transmission to HHC by Day 6, confirmed by RT-PCR with a virus subtype matching the IP. Transmission is defined as: • For ≥ 12 year olds: Fever (38.0 C or higher) and one respiratory symptom, OR one respiratory and one systemic symptom. • For <12 year olds: Fever (38.0 C or higher) and signs of an upper respiratory tract infection., Part B (Transmission) 11. Incidence of influenza transmission to HHC by Day 10, confirmed by RT-PCR with a virus subtype matching the index patient. Transmission is defined as: For ≥ 12 year old: Fever (38.0 C or higher) and one respiratory symptom, OR one respiratory and one systemic symptom. For <12 year old: Fever (38.0 C or higher) and signs of an upper respiratory tract infection.

Source: https://euclinicaltrials.eu/ctis-public/view/2023-504672-22-00